EU clinical trial 2025-524078-40-00: An open-label, multi-center protocol for patients who have completed a previous Novartis sponsored remibrutinib study and are judged by the investigator to benefit from continued treatment with remibrutinib
Protocol code: CLOU064A2306B
Sponsor: Novartis Pharma AG (Pharmaceutical company). Phase: Therapeutic confirmatory (Phase III). Countries: Germany (authorised, recruitment pending), Spain (ongoing, recruiting), France (ongoing, recruiting), Poland (ongoing, recruiting), Bulgaria (ongoing, recruiting), Czechia (ongoing, recruiting).
Therapeutic area(s): Diseases [C] - Skin and Connective Tissue Diseases [C17]
Gender: Female, Male. Age: 18-64 years, 65+ years. Enrolment: 154.
Start date (EU): 2026-06-10. Decision date: 2026-05-20. Results received: No. Last updated: 2026-06-29.
Decision dates by country: BG: 2026-05-26, CZ: 2026-05-20, DE: 2026-05-21, ES: 2026-05-27, PL: 2026-05-29, FR: 2026-05-27

Condition(s): Chronic Spontaneous Urticaria
Product: LOU064

Primary endpoint: Serious adverse events (SAEs), adverse events (AEs)

Source: https://euclinicaltrials.eu/ctis-public/view/2025-524078-40-00